EU clinical trial 2022-502606-33-00: A Phase III, Randomized, Controlled, Multi-center, 3-Arm Study of Neoadjuvant Osimertinib as Monotherapy or in Combination with Chemotherapy versus Standard of Care Chemotherapy Alone for the Treatment of Patients with Epidermal Growth Factor Receptor Mutation Positive, Resectable Non-small Cell Lung Cancer (NeoADAURA)
Protocol code: D516AC00001
Sponsor: AstraZeneca AB (Pharmaceutical company). Phase: Therapeutic confirmatory (Phase III). Countries: Germany (ongoing, recruitment ended), Bulgaria (ongoing, recruitment ended), Spain (ongoing, recruitment ended), France (ongoing, recruitment ended), Poland (ongoing, recruitment ended), Italy (ongoing, recruitment ended), Austria (ongoing, recruitment ended).
Therapeutic area(s): Analytical,Diagnostic,Therapeutic Techniques and Equipment [E]-Surgical Procedures, Operative [E04]; Diseases [C] - Hemic and Lymphatic Diseases [C15]; Psychiatry and Psychology [F] - Behavioral Disciplines and Activities [F04]; Diseases [C] - Neoplasms [C04]
Gender: Female, Male. Age: 18-64 years, 65+ years. Enrolment: 40.
Status: Ongoing, recruitment ended. Start date (EU): 2021-02-26. Decision date: 2024-05-14. Results received: No. Last updated: 2026-03-06.
Decision dates by country: ES: 2024-05-14, PL: 2024-05-27, FR: 2024-05-17, DE: 2024-06-12, IT: 2024-05-20, AT: 2024-06-17, BG: 2024-06-10

Condition(s): Patients with histologically or cytologically documented non-squamous NSCLC with completely resectable (Stage II - IIIB N2) disease
Product: CISPLATIN, Armisarte 25 mg/ml concentrate for solution for infusion, CARBOPLATIN, PEMETREXED, TAGRISSO 80 mg film-coated tablets, PLACEBO, TAGRISSO 40 mg film-coated tablets

Primary endpoint: Major Pathological Response (MPR) (≤10% residual cancer cells in the main tumour, as assessed per central pathology laboratory post surgery)
Endpoint(s): Complete pathological Response (pCR) (absence of any residual cancer cells in the dissected tumour samples, including the main tumour and lymph nodes, assessed post-surgery); EFS; DFS; Downstaging; Overall Survival (OS), Change from baseline in Patient reported outcomes (ePRO), Concordance of EGFRm status between tumour tissue DNA and patientmatched plasma-derived ctDNA, Concordance of EGFR mutation status between the local and central cobas EGFR mutation test results from baseline tumour samples., PK plasma concentrations of osimertinib

Source: https://euclinicaltrials.eu/ctis-public/view/2022-502606-33-00